EU clinical trial 2022-502677-42-00: Efficacy and safety of co-administered cagrilintide and semaglutide (CagriSema) s.c. in doses 2.4 mg/2.4 mg and 1.0 mg/1.0 mg once weekly versus placebo in participants with type 2 diabetes inadequately controlled on diet and exercise.
Protocol code: NN9388-4895
Sponsor: Novo Nordisk A/S (Pharmaceutical company). Phase: Therapeutic confirmatory (Phase III). Countries: Italy (ended), Hungary (ended), Poland (ended).
Therapeutic area(s): Diseases [C] - Nutritional and Metabolic Diseases [C18]
Gender: Female, Male. Age: 18-64 years, 65+ years. Enrolment: 60.
Status: Ended. Start date (EU): 2024-07-24. End date (EU): 2025-12-18. End date: 2025-12-22. Decision date: 2024-04-10. Results received: No. Last updated: 2026-01-28.
Decision dates by country: HU: 2024-04-11, PL: 2024-04-12, IT: 2024-04-10

Condition(s): Type 2 diabetes
Product: cagrilintide semaglutide, cagrilintide semaglutide, cagrilintide semaglutide, cagrilintide semaglutide, cagrilintide semaglutide, Placebo + Placebo

Primary endpoint: Change in HbA1c from baseline (week 0) to end of treatment (week 40)
Endpoint(s): Relative change in body weight from baseline (week 0) to end of treatment (week 40), Achievement of ≥ 10 % weight reduction from baseline (week 0) to end of treatment (week 40), Achievement of ≥ 15 % weight reduction from baseline (week 0) to end of treatment (week 40), Achievement of HbA1c target values of <7.0% (<53 mmol/mol) at end of treatment (week 40), Achievement of HbA1c target values of ≤6.5% (≤48 mmol/mol) at end of treatment (week 40), Change in Fasting Plasma Glucose (FPG) from baseline (week 0) to end of treatment (week 40), Achievement of ≥ 5% weight reduction from baseline (week 0) to end of treatment (week 40), Achievement of ≥ 20% weight reduction from baseline (week 0) to end of treatment (week 40), Change in waist circumference from baseline (week 0) to end of treatment (week 40), Change in systolic blood pressure (SBP) from baseline (week 0) to end of treatment (week 40), Change in diastolic blood pressure (DBP) from baseline (week 0) to end of treatment (week 40), Ratio to baseline in high sensitivity C-reactive protein (hsCRP) from baseline (week 0) to end of treatment (week 40), Ratio to baseline in lipids: Total cholesterol, High-density lipoprotein (HDL) cholesterol, Low-density lipoprotein (LDL) cholesterol, Very low-density lipoprotein (VLDL) cholesterol, Triglycerides, Free fatty acids, Non-HDL cholesterol from baseline (week 0) to end of treatment (week 40), Achievement of T2D remission (HbA1c<6.5% and no antidiabetic medication) at end of study (end of treatment + 12 weeks), Ratio to baseline in OGTT based oral glucose disposition index (DIo) from baseline (week 0) to end of treatment (week 40), Change in experienced level of energy, as measured by the SF-36v2 Vitality score from baseline (week 0) to end of treatment (week 40), Change in SF-36v2 score: Physical Component Summary score, Mental Component Summary score from baseline (week 0) to end of treatment (week 40), Change in Diabetes Treatment Satisfaction Questionnaire (DTSQ) score from baseline (week 0) to end of treatment (week 40), Change in leptin from baseline (week 0) to end of treatment (week 40), Change in soluble leptin receptor from baseline (week 0) to end of treatment (week 40), Number of Treatment Emergent Adverse Events (TEAEs) from baseline (week 0) to end of treatment + 7 weeks, Number of clinically significant hypoglycaemic episodes (level 2) (<3.0 mmol/L (54 mg/dL), confirmed by BG meter) from baseline (week 0) to end of treatment + 7 weeks, Number of severe hypoglycaemic episodes (level 3): hypoglycaemia associated with severe cognitive impairment requiring external assistance for recovery, with no specific glucose threshold from baseline (week 0) to end of treatment + 7 weeks

Source: https://euclinicaltrials.eu/ctis-public/view/2022-502677-42-00